EU clinical trial 2025-522500-24-00: IMCISION: Towards organ preservation and cure via ultra-short immunotherapy in advanced oral cancer. The IMCISION II trial, an investigator-initiated multicentre randomised phase 3 trial (M24IMS)
Sponsor: Het Nederlands Kanker Instituut-Antoni van Leeuwenhoek Ziekenhuis Stichting (Hospital/Clinic/Other health care facility). Phase: Therapeutic confirmatory (Phase III). Countries: Netherlands (ongoing, recruiting).
Therapeutic area(s): Diseases [C] - Neoplasms [C04]
Gender: Female, Male. Age: 18-64 years, 65+ years. Enrolment: 308.
Status: Ongoing, recruiting. Start date (EU): 2026-01-20. Decision date: 2025-12-12. Results received: No. Last updated: 2025-12-12.

Condition(s): Head and Neck squamous cell carcinoma
Product: YERVOY 5 mg/ml concentrate for solution for infusion, OPDIVO 10 mg/mL concentrate for solution for infusion.

Primary endpoint: The percentage of patients in arm A with a CCR and organ preservation of the face and oral cavity at 24 months of FU*. Success is defined with a lower bound of the 95% CI >10%., Non-inferiority of arm A compared to arm B in Recurrence Free Survival (RFS) after a minimum FU of 24 months since randomisation for each patient. An event is defined as disease progression to unresectable disease before surgery or before adjuvant (C)RT, OR recurrent disease after treatment, OR death due to any cause.
Endpoint(s): The CCR rate in ARM A at 12 and 18 months, To assess the difference in Qol between Arm A and B on all domains of the EORTC QLQ H&N43 and the EORTC QLQ-C30, EQ-5D-5L, HADS. • And between the responders in Arm A vs Arm B. • And between the non-responders of Arm A vs Arm B. • And between responders and non-responders of arm A, Compare other survival endpoints between Arm A and B (Locoregional control (LRC), dis-tant metastasis free survival (DMFS), Disease specific survival (DSS), Recurrence Free Sur-vival (RFS), Event Free Survival (EFS) and Overall survival (OS)) at 12, 18 and 24 months FU, Compare AEs and ir-AEs in both arms using the CTCAE v5.0 and Clavien-Dindo up to 100 days after last treatment (immunotherapy, surgery or adjuvant (C)RT), Cost-effectiveness of ARM A will be compared to ARM B in terms of incremental costs and quality adjusted life years, Treatment duration and stops of ARM A will be compared to ARM B., Extent of surgery (type and hours), RT( days and total Gy), chemotherapy (typaeand cumulative dose), days of admission on the ward, visits, other interventions, etc. • Comparison between ARM A and B • Between the responders in Arm A vs Arm B. • And between the non-responders of Arm A vs Arm B. • And between responders and non-responders of arm A

Source: https://euclinicaltrials.eu/ctis-public/view/2025-522500-24-00